EU clinical trial 2022-501551-90-00: Treatment of High-Risk Prostate Cancer Guided by Novel Diagnostic Radio- and Molecular Tracers (THUNDER): A Two-part Phase 2/3 Trial
Protocol code: CTO21042GZA
Sponsor: Ziekenhuis Aan De Stroom (Hospital/Clinic/Other health care facility). Phase: Phase II and Phase III (Integrated). Countries: Belgium (ongoing, recruiting), Spain (ongoing, recruiting).
Therapeutic area(s): Diseases [C] - Neoplasms [C04]
Gender: Male. Age: 18-64 years, 65+ years. Enrolment: 493.
Status: Ongoing, recruiting. Start date (EU): 2023-12-13. Decision date: 2023-09-20. Results received: No. Last updated: 2026-07-13.
Decision dates by country: BE: 2023-09-20, ES: 2026-01-23

Condition(s): Prostate cancer
Product: Docetaxel AB 20 mg/ml concentraat voor oplossing voor infusie, BAY 1841788, Docetaxel Accord 160 mg/8 ml concentrate for solution for infusion, Docetaxel AB 20 mg/ml concentraat voor oplossing voor infusie, TAXOTERE 160 mg/8 ml concentrate for solution for infusion., Docetaxel AB 20 mg/ml concentraat voor oplossing voor infusie, ZOLADEX, 3,6 mg, implant, DEPO-ELIGARD 22,5 mg, poeder en oplosmiddel voor oplossing voor injectie, Decapeptyl Sustained Release 3,75 mg Pulver und Lösungsmittel zur Herstellung einer Injektionssuspension, Decapeptyl Sustained Release 22,5 mg, poeder en oplosmiddel voor suspensie voor injectie met verlengde afgifte, ZOLADEX Long Acting, 10,8 mg, implant, Docetaxel Accord 80 mg/4 ml concentrate for solution for infusion, Placebo of BAY 1841788, DEPO-ELIGARD 45 mg, poeder en oplosmiddel voor oplossing voor injectie, TAXOTERE 80 mg/4 ml concentrate for solution for infusion, FIRMAGON 80 mg powder and solvent for solution for injection, Orgovyx 120 mg film-coated tablets, Decapeptyl Sustained Release 11,25 mg Pulver und Lösungsmittel zur Herstellung einer Injektionssuspension, Docetaxel Accord 20 mg/1 ml concentrate for solution for infusion, Docetaxel AB 20 mg/ml concentraat voor oplossing voor infusie, DEPO-ELIGARD 7,5 mg, poeder en oplosmiddel voor oplossing voor injectie, Orgovyx 120 mg film-coated tablets, FIRMAGON 120 mg powder and solvent for solution for injection

Primary endpoint: Phase 3 Intensification study: Incidence of ppMFS over time. PSMA PET metastatic progression is defined as the appearance of at least 1 new PSMA-PET-positive distant lesion compared with the baseline scan or date of death from any cause., Phase 2 De-intensification study: Health related Quality of Life (HRQL) will be reported by subjects using the Expanded Prostate Cancer Index Composite (EPIC) questionnaire. A clinically important point reduction in EPIC subdomain score is defined as follows: sexual (11 points), and hormonal (5 points) as detected at 12 months. EPIC scores will be measured on a yearly basis to monitor late effects.
Endpoint(s): OS will be measured from the date of randomization to the date of death or last known follow-up date, with patients alive at the last known follow-up time treated as censored, Prostate cancer-specific mortality (PCSM) will be measured from the date of randomization to the date of prostate cancer death., Biochemical progression-free survival will be measured from the date of randomization to the date event, or death or censored at the last known follow-up date. Events are PSA failure, castrate resistance (EAU Guidelines on Prostate Cancer 2022), receiving salvage therapy, or death from any cause., Time to next systemic therapy (NEST) will be measured from date of randomization to time of death, or censored at the last known follow-up date. Events for NEST are receiving any local therapy (surgery, radiotherapy, HIFU, cryotherapy) or systemic therapy for prostate cancer., Counts of all AEs by grade will be provided by study (Phase 2 and 3) and treatment arm, EPIC mean changes in subdomain scores over time will be compared, both for change from baseline and absolute health related quality of life scores.

Source: https://euclinicaltrials.eu/ctis-public/view/2022-501551-90-00